EU clinical trial 2023-507278-41-00: An open-label, single arm, multicenter extension study to evaluate long-term safety and tolerability of inclisiran in participants with heterozygous or homozygous familial hypercholesterolemia who have completed the adolescent ORION-16 or ORION-13 studies (VICTORION-PEDS-OLE)
Protocol code: CKJX839C12001B
Sponsor: Novartis Pharma AG (Pharmaceutical company). Phase: Therapeutic confirmatory (Phase III). Countries: Germany (ongoing, recruitment ended), Spain (ongoing, recruitment ended), Hungary (ongoing, recruiting), Norway (ongoing, recruitment ended), Netherlands (ongoing, recruitment ended), Poland (ongoing, recruitment ended), France (ongoing, recruitment ended), Italy (ongoing, recruitment ended), Slovenia (ongoing, recruitment ended), Greece (ongoing, recruitment ended), Slovakia (ongoing, recruitment ended), Czechia (ongoing, recruitment ended).
Therapeutic area(s): Diseases [C] - Cardiovascular Diseases [C14]
Gender: Female, Male. Age: 0-17 years, 18-64 years. Enrolment: 62.
Start date (EU): 2023-02-10. Decision date: 2023-11-30. Results received: No. Last updated: 2026-01-15.
Decision dates by country: HU: 2023-12-01, ES: 2023-11-30, SI: 2023-12-14, DE: 2023-12-05, NO: 2023-12-01, GR: 2024-01-24, NL: 2023-12-05, PL: 2023-12-01, CZ: 2024-11-28, SK: 2024-11-14, FR: 2023-12-01, IT: 2023-12-11

Condition(s): Familial hypercholsterolemia
Product: INCLISIRAN

Primary endpoint: Treatment-emergent adverse events (TEAEs) and serious adverse events (TESAEs) (incidence, severity, relationship to study drug and discontinuation due to TEAEs); vital signs; growth; laboratory parameters
Endpoint(s): Percentage change and absolute change in LDL-C from baseline in the feeder study to end of study (EoS)

Source: https://euclinicaltrials.eu/ctis-public/view/2023-507278-41-00